EU clinical trial 2024-514545-11-00: Phase III, multicentre, randomized, open clinical trial comparing treatment with allogenic mesenchymal cells against autologous mesenchymal cells and against active control with hyaluronic acid in patients with knee osteoarthritis.
Protocol code: ARTROCELL
Sponsor: Fundacion De Investigacion Biomedica De Salamanca (Laboratory/Research/Testing facility). Phase: Therapeutic confirmatory (Phase III). Countries: Spain (ongoing, recruitment ended).
Therapeutic area(s): Diseases [C] - Musculoskeletal Diseases [C05]
Gender: Female, Male. Age: 18-64 years, 65+ years. Enrolment: 120.
Status: Ongoing, recruitment ended. Start date (EU): 2021-05-26. Decision date: 2024-11-05. Results received: No. Last updated: 2025-11-12.

Condition(s): Knee osteoarthritis
Product: Autologous BM-MSC, HYALURONIC ACID, Allogenic BM-MSC

Primary endpoint: Measurement of pain intensity according to the VAS pain scale at 12 months., Assessment of functional capacity and pain according to the Lequesne scale at 12 months, Measurement of symptomatology and perceived physical disability according to the WOMAC scale at 12 months., Estimation of lesion improvement or stabilisation on T2-mapping MR images at 12 months.
Endpoint(s): Assessment of perceived quality of life on the SF-12 scale at 6, 12 and 24 months., Rate of products not complying with the validation criteria in each experimental treatment branch., Rate of autologous products that could not be manufactured due to alterations in the serological profile of the patients., Rate of medication-related adverse effects in each of the treatment arms., Cell product studies. In this exploratory objective, genomic studies will be performed by RNA-seq and open array on the advanced therapy drugs manufactured in the study (both autologous and allogeneic), and a correlation will be made with clinical and biological parameters and response, but they are not included in the explicit secondary variables, because they will also require subsequent validation., Biological studies to evaluate the immune system in the patient's blood and serum (days +7 and +30) As these are exploratory objectives, statistical analyses of correlations between the results of the biological variables and the clinical parameters will be carried out, but they are not included among the explicit secondary variables, because they will also require subsequent validation.

Source: https://euclinicaltrials.eu/ctis-public/view/2024-514545-11-00